EU clinical trial 2025-520820-44-00: Comparison between Ropivacain and Lidocain used as local anaesthesia regarding postoperative pain outcome after tonsillectomy
Sponsor: Tauernkliniken GmbH A.ö. Tauernklinikum - Standort Zell am See (Health care). Phase: Therapeutic use (Phase IV). Countries: Austria (ongoing, recruiting).
Therapeutic area(s): Diseases [C] - Otorhinolaryngologic Diseases [C09]
Gender: Female, Male. Age: 18-64 years, 65+ years. Enrolment: 60.
Status: Ongoing, recruiting. Start date (EU): 2025-06-26. Decision date: 2025-06-22. Results received: No. Last updated: 2026-05-25.

Condition(s): Chronic Tonsillitis
Product: PIRITRAMIDE, METAMIZOLE SODIUM MONOHYDRATE, L-Adrenalin "Fresenius" spritzfertig 2,0 mg - Ampullen, BENZYDAMINE HYDROCHLORIDE, DICLOFENAC SODIUM, Ropivacainhydrochlorid Sintetica 5 mg/ml Injektionslösung, METAMIZOLE SODIUM, Xylanaest 0,5 % mit Epinephrin 1:200.000 - Durchstechflaschen, PANTOPRAZOLE

Primary endpoint: The primary endpoint of the study is the average postoperative pain score, measured using the Visual Analog Scale (VAS, 0–10), within the first 72 hours after tonsillectomy. Assessments will be conducted four times daily, for a total of 12 measurements.
Endpoint(s): Average postoperative pain score measured using the Visual Analog Scale (VAS, 0–10) after discharge, assessed four times daily for a total of 11 days (Day 4–14), Average amount of analgesics taken during the inpatient stay (Day 1–4), differentiated by two types of analgesic medications, Average amount of analgesics taken during the inpatient stay (Day 1–4), differentiated by two types of analgesic medications, Time to first rescue medication in hours and minutes from the end of surgery to administration

Source: https://euclinicaltrials.eu/ctis-public/view/2025-520820-44-00